EU clinical trial 2024-517091-38-00: A study to test whether treatment with BI 770371 in combination with pembrolizumab with or without cetuximab helps people with head and neck cancer compared with pembrolizumab alone
Protocol code: 1501-0002
Sponsor: Boehringer Ingelheim International GmbH (Pharmaceutical company). Phase: Human Pharmacology (Phase I)- Other. Countries: Poland (ended), Germany (ongoing, recruitment ended), Hungary (ended), Romania (ongoing, recruitment ended), Bulgaria (authorised, recruiting), Italy (authorised, recruiting), Spain (ongoing, recruitment ended), France (ongoing, recruitment ended).
Therapeutic area(s): Diseases [C] - Neoplasms [C04]
Gender: Female, Male. Age: 18-64 years, 65+ years. Enrolment: 55.
Start date (EU): 2025-11-25. Decision date: 2025-05-22. Results received: No. Last updated: 2026-04-20.
Decision dates by country: ES: 2025-05-23, RO: 2025-05-27, HU: 2025-05-27, FR: 2025-05-22, DE: 2025-05-23, IT: 2025-05-23, PL: 2025-05-25, BG: 2025-05-28

Condition(s): Head and neck squamous cell carcinoma

Source: https://euclinicaltrials.eu/ctis-public/view/2024-517091-38-00